EU clinical trial 2024-516847-23-00: DOLAF : An international multicenter phase II trial of Durvalumab (MEDI4736) plus OLAparib plus Fulvestrant in metastatic or locally advanced ER-positive, HER2-negative breast cancer patients selected using criteria that predict sensitivity to olaparib
Protocol code: UC-0140/1812
Sponsor: Unicancer (Hospital/Clinic/Other health care facility). Phase: Therapeutic exploratory (Phase II). Countries: Spain (ongoing, recruitment ended), Belgium (ongoing, recruitment ended), France (ongoing, recruitment ended).
Therapeutic area(s): Diseases [C] - Neoplasms [C04]
Gender: Female, Male. Age: 18-64 years, 65+ years. Enrolment: 172.
Status: Ongoing, recruitment ended. Start date (EU): 2019-08-27. Decision date: 2024-10-21. Results received: No. Last updated: 2026-01-12.
Decision dates by country: FR: 2024-10-22, ES: 2024-10-21, BE: 2024-10-21

Condition(s): ER-positive and HER2-negative metastatic or locally advanced breast cancer with either a germline or somatic BRCA mutation, or a deleterious alteration of other genes involved in homologous recombination repair (HRR) or in MSI status.
Product: Lynparza 100 mg film-coated tablets, IMFINZI 50 mg/mL concentrate for solution for infusion., Faslodex 250 mg solution for injection., Lynparza 150 mg film-coated tablets, Zoladex 3.6 mg Implant

Primary endpoint: The progression-free survival rate at 24 weeks defined as the percentage of patients alive without disease progression at 24 weeks after inclusion. PFSR will be evaluated by local investigator using Response Evaluation Criteria in Solid Tumours version 1.1 (RECIST v1.1). The death of a patient for any cause within 24 weeks will be considered as failure.
Endpoint(s): Safety endpoint in overall and germline BRCA mutated populations 1. The safety will be evaluated according to the NCI-CTCAE v5.0., Efficacy endpoint in the overall study population 1. OS is defined as the interval between the date of inclusion and the date of death from any cause. A patient alive will be censored at the last date of follow-up., The RECIST v1.1 will be used to determine: 2. The ORR defined as the percent of patients with a complete response (CR) or a partial response (PR)., 3. The DoR defined as the duration between the time measurement criteria are first met for CR or PR until the first date that recurrent disease is objectively documented, 4. PFS defined as the interval between the date of inclusion and the date of progression or death. A patient alive and without progression will be censored at the last date of follow-up., Efficacy endpoint in the germline BRCA mutated population 1. OS is defined as the interval between the date of inclusion and the date of death from any cause. A patient alive at analysis will be censored at the last date of follow-up., The RECIST v1.1 will be used to determine: 2. PFSR at 24 weeks defined as the percentage of patients without disease progression and who are alive at 24 weeks after inclusion. The death of a patient for any cause within 24 weeks will be considered as failure., 3. The ORR defined as the number and the percent of patients with a CR or PR., 4. The DoR defined as the duration between the time measurement criteria are first met for CR or PR until the first date that recurrent disease is objectively documented., 5. PFS defined as the interval between the date of inclusion and the date of progression or death. A patient alive and without progression at analysis will be censored at the last date of follow-up., Exploratory analysis to evaluate efficacy in terms of OS, PFS, ORR, and DoR and safety will be performed in patients: 1. Previously treated with CDK4/6 inhibitors. 2. With different PD-L1 expression status.

Source: https://euclinicaltrials.eu/ctis-public/view/2024-516847-23-00